EU clinical trial 2022-500419-38-00: Prospective randomized double-blind study evaluating the superiority of VAsopressin versus NOradrenaline in the management of the renal risk patient undergoing cardiac surgery with extracorporeal circulation
Sponsor: Centre Hospitalier Universitaire Dijon Bourgogne (Hospital/Clinic/Other health care facility). Phase: Therapeutic confirmatory (Phase III). Countries: France (ongoing, recruitment ended).
Therapeutic area(s): Analytical, Diagnostic and Therapeutic Techniques and Equipment [E] - Anesthesia and Analgesia [E03]
Gender: Female, Male. Age: 18-64 years, 65+ years. Enrolment: 840.
Status: Ongoing, recruitment ended. Start date (EU): 2022-12-28. Decision date: 2022-08-01. Results received: No. Last updated: 2023-08-23.

Condition(s): vasoplegic syndrome
Product: REVERPLEG 40 U.I./2 mL, solution à diluer pour perfusion, NORADRENALINE RENAUDIN 2 mg/ml SANS CONSERVATEUR, solution à diluer pour perfusion

Primary endpoint: Occurrence of a renal complication or death from the onset of vasoplegic syndrome until 7 days after. Renal complications are defined as the occurrence of acute kidney failure as defined by the KDIGO definition (stage 1 or higher), and/or the initiation of renal replacement therapy
Endpoint(s): The occurrence of a renal complication (as defined in the primary endpoint) or death within 90 days of the onset of vasoplegic syndrome, Mortality within 90 days of the onset of vasoplegic syndrome, Occurrence of a cardiac complication as listed below at 7, 30, and 90 days after the onset of vasoplegic syndrome: arrhythmia requiring treatment , postoperative myocardial damage, myocardial infarction defined by an increase in cardiac enzymes plus the appearance of a new Q wave, and/or an abnormality of kinetics on echocardiography, cardiorespiratory arrest, The occurrence of a digestive complication as listed below at 7, 30 and 90 days after the onset of the vasoplegic syndrome: mesenteric ischemia, ischemic colitis diagnosed by an imaging examination (CT scan, endoscopy) or the need for a reoperation for digestive complication in the aftermath of the cardiac surgery, The occurrence of a cerebral complication as listed below within 7 days of the onset of the vasoplegic syndrome: stroke, delirium (identified by the CAM-ICU test), The number of patients requiring rescue norepinephrine after the onset of vasoplegic syndrome in the OR and postoperatively, The total dose (mg) of norepinephrine for patients requiring rescue norepinephrine after the onset of vasoplegic syndrome in the OR and postoperatively, The Vasoactive Inotropic Score at D0, D1, D2, D7 of the onset of the vasoplegic syndrome (VIS = dopamine dose (mcg kg-1 min-1) + dobutamine dose (mcg kg-1 min-1) + 100 x adrenaline dose (mcg kg-1 min- 1) + 10 x dose of milrinone (mcg kg-1 min-1) + 10,000 x dose of vasopressin (units/kg/min) + 100 x dose of norepinephrine (mcg kg-1 min-1) + 10 x dose of phenylephrine (mcg kg-1 min-1), The length of stay in the ICU and hospital (number of days) at D90 of the onset of the vasoplegic syndrome, The difference in mean costs of ICU and hospital stays at D90 of vasoplegic syndrome onset, The incremental cost-effectiveness ratio at D90 of onset of vasoplegic syndrome, expressed as the cost per additional complication avoided by the vasopressin strategy compared with the noradrenaline strategy, The incremental cost-effectiveness ratio at D90 of the onset of vasoplegic syndrome, expressed as the cost per additional year of life gained with the vasopressin strategy compared with the noradrenaline strategy, Incremental cost-effectiveness ratio at D90 of the onset of vasoplegic syndrome, expressed in terms of cost per additional healthy life-year gained (cost/QALY) with the vasopressin strategy compared with the noradrenaline strategy, The occurrence of hyponatremia (Na+ <130 mmol l-1), hypoperfusion of the extremities (cyanosis/necrosis of the extremities) at D7

Source: https://euclinicaltrials.eu/ctis-public/view/2022-500419-38-00